EU clinical trial 2023-506235-15-00: A Phase 3, Randomized, Double-blind, Placebo-controlled, Multicenter Study of Tarlatamab Therapy in Subjects With Limited-Stage Small-Cell Lung Cancer (LS SCLC) who Have not Progressed Following Concurrent Chemoradiation Therapy (DeLLphi-306)
Protocol code: 20230016
Sponsor: Amgen Inc. (Pharmaceutical company). Phase: Therapeutic confirmatory (Phase III). Countries: Austria (ended), Portugal (ongoing, recruitment ended), Poland (ongoing, recruitment ended), France (ongoing, recruitment ended), Sweden (ended), Bulgaria (ongoing, recruitment ended), Belgium (ended), Spain (ongoing, recruitment ended), Italy (ongoing, recruitment ended), Greece (ongoing, recruitment ended), Germany (ongoing, recruitment ended), Romania (ongoing, recruitment ended).
Therapeutic area(s): Diseases [C] - Neoplasms [C04]
Gender: Female, Male. Age: 18-64 years, 65+ years. Enrolment: 145.
Start date (EU): 2024-11-07. Decision date: 2024-06-03. Results received: No. Last updated: 2026-07-30.
Decision dates by country: SE: 2024-06-10, AT: 2024-06-04, BE: 2024-06-03, IT: 2024-06-05, ES: 2024-06-06, DE: 2024-06-06, RO: 2024-06-10, FR: 2024-06-07, PL: 2024-06-10, PT: 2024-06-04, GR: 2024-06-10, BG: 2024-06-10

Condition(s): Limited-Stage Small-Cell Lung Cancer (LS SCLC)
Product: VASOPRESSIN (ARGIPRESSIN), DEXAMETHASONE, SILTUXIMAB, ELECTROLYTES, Tarlatamab, PARACETAMOL, PREDNISOLONE, TOCILIZUMAB, Placebo for Tarlatamab (AMG-757), Tarlatamab

Primary endpoint: PFS (BICR), OS
Endpoint(s): PFS (investigator), Complete response (CR) based on BICR and investigator assessment per RECIST 1.1. XX based on BICR and investigator assessment per RECIST 1.1. Duration of complete response., "PFS and OS rate at 6 months, 1 and 2 years from randomization. OS rate at 6 months, 1 year, 2 years and 3 years from randomization. TTP ", Incidence of treatment-emergent adverse events after randomization, Serum concentration of tarlatamab, Incidence of anti-tarlatamab antibody formation

Source: https://euclinicaltrials.eu/ctis-public/view/2023-506235-15-00